EU clinical trial 2022-502697-16-00: SEER-3: A Phase 3, Multi-Center, Randomized, Parallel, Double Masked, Placebo-Controlled Clinical Study to Assess the Safety and Efficacy of 0.1% RGN-259 Ophthalmic Solution for the Treatment of Neurotrophic Keratopathy
Protocol code: SEER-3
Sponsor: Regentree LLC (Pharmaceutical company). Phase: Therapeutic confirmatory (Phase III). Countries: Italy (ended), Spain (ended), Germany (ended), Poland (ended).
Therapeutic area(s): Diseases [C] - Eye Diseases [C11]
Gender: Female, Male. Age: 18-64 years, 65+ years. Enrolment: 70.
Status: Ended. Start date (EU): 2023-08-29. End date (EU): 2025-02-04. Decision date: 2023-06-07. Results received: Yes. Last updated: 2025-04-14.
Decision dates by country: IT: 2023-06-07, ES: 2023-06-12, DE: 2023-10-17, PL: 2023-10-23

Condition(s): Neurotrophic Keratopathy
Product: Timbetasin acetate ophthalmic solution 0.1%, The placebo has the identical composition as the DP except it does not contain timbetasin acetate.

Primary endpoint: Percentage of subjects achieving complete healing (defined as 0 mm lesion size) of the Persistent Epithelial Defect (PED) at Visit 5 (Day 29) determined by corneal fluorescein staining as measured by the Central Reading Center. The size of the lesion is based on the longest dimension (length or width) of the defect, Safety as determined by the frequency and severity of AEs as reported according to the NCI CTCAE version 5.0, changes from baseline in vital signs, changes in intraocular pressure (IOP), and results of the dilated fundoscopy and slit-lamp exams for both eyes
Endpoint(s): Percentage of subjects achieving complete healing (defined as 0 mm lesion size) of the PED determined by corneal fluorescein staining as measured by the Central Reading Center at Visits 2, 3, 4, 6, and 7, Percentage of subjects achieving complete healing (defined as <0.5 mm lesion size) of the PED determined by corneal fluorescein staining as measured by the Investigator at Visits 2-7, Time to complete healing of the PED as measured by the Central Reading Center, Time to complete healing of the PED as measured by the Investigator, Percentage change from baseline of lesion size determined by corneal fluorescein staining as measured by the Central Reading Center at Visit 2-7 (measurements of greatest dimension of fluorescein staining), Percentage change from baseline of lesion size determined by corneal fluorescein staining as measured by the Investigator at Visit 2-7 (measurements of greatest dimension of fluorescein staining), NK stage (Mackie Classification) determined by corneal fluorescein staining as measured by the Investigator at Visits 2-7, Visual Acuity determined by Early Treatment of Diabetic Retinopathy Study (ETDRS) at Visits 2-7, Corneal sensitivity inside the lesion determined by Cochet Bonnet aesthesiometer at Visits 2-7, Change from baseline in Ocular discomfort, Photophobia, Foreign body sensation, Burning and Dryness using VAS at Visit 3 and Visit 5, Proportion of subjects achieving complete healing (defined as 0 mm lesion size) of the PED determined by corneal fluorescein staining as measured by the Central Reading Center over multiple visits from visit 2 to visit 5, Proportion of subjects achieving complete healing (defined as <0.5 mm lesion size) of the PED determined by corneal fluorescein staining as measured by the Investigator over multiple visits from visit 2 to visit 5

Source: https://euclinicaltrials.eu/ctis-public/view/2022-502697-16-00